EU clinical trial 2025-521674-33-00: A phase 2a Safety and Efficacy study of TAR-0520 gel in prevention of taxanes-induced peripheral neuropathy
Protocol code: TARIAN 014
Sponsor: Tarian Pharma (Pharmaceutical company). Phase: Therapeutic exploratory (Phase II). Countries: France (ongoing, recruiting).
Therapeutic area(s): Diseases [C] - Nervous System Diseases [C10]
Gender: Female, Male. Age: 18-64 years, 65+ years. Enrolment: 30.
Status: Ongoing, recruiting. Start date (EU): 2025-11-05. Decision date: 2025-06-27. Results received: No. Last updated: 2025-06-27.

Condition(s): Taxanes-induced peripheral neuropathy
Product: TAR-0520 Gel

Primary endpoint: Incidence of Adverse Events, Adverse Events of Special Interest and Serious Adverse Events
Endpoint(s): Incidence and severity of NCI-CTCAE (Nervous system disorders) grading by oncologist

Source: https://euclinicaltrials.eu/ctis-public/view/2025-521674-33-00